EU clinical trial 2024-519971-25-00: IFCT-2404 COMET A Randomized Controlled Trial of Tepotinib vs Standard Treatment in Patients with Advanced MET exon 14 Mutated Non-Small Cell Lung Cancer
Sponsor: Intergroupe Francophone De Cancerologie Thoracique (Patient organisation/association). Phase: Therapeutic confirmatory (Phase III). Countries: France (ongoing, recruiting).
Therapeutic area(s): Diseases [C] - Neoplasms [C04]
Gender: Female, Male. Age: 18-64 years, 65+ years. Enrolment: 133.
Status: Ongoing, recruiting. Start date (EU): 2025-12-03. Decision date: 2025-06-11. Results received: No. Last updated: 2025-06-11.

Condition(s): Advanced MET exon 14 Mutated Non-Small Cell Lung Cancer
Product: NIVOLUMAB, GEMCITABINE, TEPMETKO 225 mg film-coated tablets, PACLITAXEL, DOCETAXEL, ATEZOLIZUMAB, BEVACIZUMAB, PEMBROLIZUMAB, VINORELBINE, PEMETREXED

Primary endpoint: Progression-free survival (PFS) assessed by independent review committee according to RECIST 1.1.
Endpoint(s): Hierarchical analysis #1: Quality of life: change from baseline to week 6 in QLQ-C30 global health status/Quality of life (GHS/QOL) score, using the EORTC QLQ-C30 questionnaire with lung cancer module QLQ-LC29), tested if the primary endpoint (PFS) shows statistical significance., Hierarchical analysis #2: Overall survival, tested if the primary endpoint (PFS) and the first secondary endpoint (QoL) both show statistical significance., Objective Response Rate according to RECIST1.1., Duration of response., Second progression-free survival (PFS2) and Time to next treatment or death (TNT-D)., Incidence, nature, and severity of adverse events, graded according to the National Cancer Institute Common Terminology Criteria for Adverse Events, Version 5.0 (NCI CTCAE v5.0)., Number of cycles for each arm, Number of treatment dose modification and interruption.

Source: https://euclinicaltrials.eu/ctis-public/view/2024-519971-25-00